EU clinical trial 2025-520641-69-00: A randomized controlled, two-arm (1:1 ratio) Phase IIa trial to assess the efficacy and safety of obinutuzumab in treating adults with de novo minimal change disease
Protocol code: OBELIX-NEPHROSIS
Sponsor: Medizinische Universitaet Innsbruck (Educational Institution). Phase: Therapeutic exploratory (Phase II). Countries: Germany (authorised, recruitment pending), Austria (ongoing, recruiting), France (authorised, recruitment pending).
Therapeutic area(s): Diseases [C] - Immune System Diseases [C20]
Gender: Female, Male. Age: 18-64 years, 65+ years. Enrolment: 48.
Start date (EU): 2026-07-14. Decision date: 2026-04-23. Results received: No. Last updated: 2026-07-05.
Decision dates by country: FR: 2026-04-23, DE: 2026-04-23, AT: 2026-04-27

Condition(s): Kidney disease
Product: RITUXIMAB, TACROLIMUS, PREDNISONE, PREDNISOLONE, Gazyvaro 1,000 mg concentrate for solution for infusion.

Primary endpoint: Non-inferiority of obinutuzumab to SoC predniso(lo)ne taper: Proportions of patients achieving remission (complete or partial) of MCD at 8 weeks, Superiority of obinutuzumab to SoC prednis(lo)ne taper: Proportions of patients sustaining remission (complete or partial)/prevent relapses of MCD during the study period of 52 weeks
Endpoint(s): Time to remission (either complete or partial), Time to complete remission, Time to disease relapse, Change in Glucocorticoid Toxicity Index (GTI) from baseline to day 60, week 26 and 52, Change in urinary protein-to-creatinine ratio/albumin-to-creatinine ratio from baseline to week 26 and 52, Change in serum albumin from baseline to week 26 and 52, Kidney function as assessed by changes in 2021 race-free CKD-EPI estimated glomerular filtration rate (eGFR) from baseline to week 26 and 52, Patient-reported health–related QoL assessed by EuroQol 5-Dimensions 5-Levels Questionnaire (EQ-5D-5L), Predictors of disease relapse (independent of treatment assignment): Demographics, clinical characteristics, biological variables and histopathological characteristics, Safety endpoint: Serious adverse events (assessed by CTCAE v5; defined as grade ≥3) during the study period of 52 weeks, Safety endpoint: Adverse events of special interest (AESI) and infection events during the study period of 52 weeks, Safety endpoint: The proportion of patients with overall and mild hypogammaglobulinemia (<7g/L), moderate hypogammaglobulinemia (<5g/L) and severe hypogammaglobulinemia (<3g/L) at baseline, week 26 and week 52, Exploratory endpoint: Sequential measurement of anti-nephrin antibodies, and value of anti-nephrin antibodies to predict treatment response and relapse, Exploratory endpoint: Identification of B and T cell subsets to predict treatment response, relapse and side effects in the obinutuzumab and the standard of care arm, Exploratory endpoint: The association between development of anti-obinutuzumab antibodies and quantitative levels of obinutuzumab and treatment response and sustained remission rates, Exploratory endpoint: Single cell RNA sequencing signature predictive of response to treatment, time to remission, sustained remission and risk of side effects in the obinutuzumab and the standard of care arm, Exploratory endpoint: Differentially expressed proteins/lipids (assessed by plasma/PBMC proteomics and plasma lipidomics) distinguish patients who will achieve remission and will have a disease relapse

Source: https://euclinicaltrials.eu/ctis-public/view/2025-520641-69-00